EU clinical trial 2023-505862-27-00: A clinical trial to learn how an investigational drug (norucholic acid) is absorbed, distributed, broken down, and removed from the body when given to people with kidney problems
Protocol code: NUT-018/BIO
Sponsor: Dr. Falk Pharma GmbH (Pharmaceutical company). Phase: Human Pharmacology (Phase I)- Other. Countries: Hungary (ended).
Therapeutic area(s): Diseases [C] - Digestive System Diseases [C06]
Gender: Female, Male. Age: 18-64 years, 65+ years. Enrolment: 48.
Status: Ended. Start date (EU): 2023-10-10. End date (EU): 2025-04-17. Decision date: 2023-10-06. Results received: No. Last updated: 2024-05-13.

Condition(s): Nonalcoholic fatty liver disease (NAFLD), Primary sclerosing cholangitis (PSC)

Source: https://euclinicaltrials.eu/ctis-public/view/2023-505862-27-00